EU clinical trial 2023-509171-16-00: A Randomized, Double-Blind, Placebo-Controlled Study to Evaluate the Safety and Efficacy of Crinecerfont (NBI-74788) in Adult Subjects with Classic Congenital Adrenal Hyperplasia, Followed by Open-Label Treatment
Protocol code: NBI-74788-CAH3003
Sponsor: Neurocrine Biosciences Inc. (Pharmaceutical company). Phase: Therapeutic confirmatory (Phase III). Countries: Czechia (ongoing, recruitment ended), Portugal (ongoing, recruitment ended), Italy (ongoing, recruitment ended), Germany (ongoing, recruitment ended), Poland (ongoing, recruitment ended), Belgium (ongoing, recruitment ended), France (ongoing, recruitment ended), Spain (ongoing, recruitment ended), Sweden (ongoing, recruitment ended), Austria (ongoing, recruitment ended), Greece (ongoing, recruitment ended), Bulgaria (ongoing, recruitment ended).
Therapeutic area(s): Diseases [C] - Hormonal diseases [C19]
Gender: Female, Male. Age: 18-64 years, 65+ years. Enrolment: 99.
Status: Ongoing, recruitment ended. Start date (EU): 2020-11-23. Decision date: 2024-07-11. Results received: No. Last updated: 2026-06-02.
Decision dates by country: AT: 2024-07-16, BG: 2024-07-12, CZ: 2024-07-15, FR: 2024-07-11, DE: 2024-07-16, GR: 2024-09-25, IT: 2024-07-16, PT: 2024-07-12, ES: 2024-07-12, SE: 2024-07-12, PL: 2024-07-24, BE: 2024-07-11

Condition(s): Classic Congenital Adrenal Hyperplasia (CAH)
Product: NBI-74788, Crinecerfont placebo for oral capsules

Primary endpoint: Percent change from baseline in glucocorticoid daily dose (in hydrocortisone equivalents adjusted for BSA [mg/m2/day]) at Week 24.
Endpoint(s): Change from baseline in serum androstenedione at Week 4., Achievement of a reduction in glucocorticoid daily dose to physiologic levels Week 24., Changes from baseline in HOMA-IR, weight, and fat mass at Week 24

Source: https://euclinicaltrials.eu/ctis-public/view/2023-509171-16-00